EU clinical trial 2022-501089-22-00: Clinical study to test the safety, tolerance and preliminary efficacy of oral ITF3756 administered alone or in combination with an anti-protein 4 agent associated with cytotoxic T lymphocytes in patients with advanced solid tumors.
Protocol code: ITF/3756/01
Sponsor: Italfarmaco S.p.A. (Pharmaceutical company). Phase: Human Pharmacology (Phase I)- First administration to humans. Countries: Italy (ongoing, recruitment ended), Spain (ended).
Therapeutic area(s): Diseases [C] - Neoplasms [C04]
Gender: Female, Male. Age: 18-64 years, 65+ years. Enrolment: 60.
Start date (EU): 2022-11-29. Decision date: 2022-11-09. Results received: No. Last updated: 2026-07-28.
Decision dates by country: IT: 2022-11-09, ES: 2022-11-14

Condition(s): Advanced solid tumors

Source: https://euclinicaltrials.eu/ctis-public/view/2022-501089-22-00